EU clinical trial 2023-506205-18-00: A single blind, placebo controlled, single center, randomized controlled pilot study to assess if low dose ciprofloxacin can induce antimicrobial resistance in Escherichia coli
Protocol code: ITM202301
Sponsor: Institute Of Tropical Medicine (Hospital/Clinic/Other health care facility). Phase: Therapeutic exploratory (Phase II). Countries: Belgium (ended).
Therapeutic area(s): Phenomena and Processes [G] - Microbiological Phenomena [G06]
Gender: Female, Male. Age: 18-64 years, 65+ years. Enrolment: 50.
Status: Ended. Start date (EU): 2024-02-23. End date (EU): 2024-05-23. Decision date: 2023-11-13. Results received: Yes. Last updated: 2023-11-13.

Condition(s): antimicrobial resistance in Escherichia coli
Product: SyrSpend SF, Ciprofloxacin Kabi 200 mg/100 ml solution for infusion

Primary endpoint: If from the descriptive plots (see secondary objective 1) it becomes evident that there is an individual location shift (but the shape of the distribution remains the same), the individual difference in median ciprofloxacin MIC will be calculated (after intervention – baseline). Otherwise, the maximum absolute distance between the two individual empirical cumulative empirical distributions (ecdf’s) will be calculated (i.e. Kolmogorov-Smirnov test statistic).
Endpoint(s): Individual MIC distributions, Percentage of inhibited E. coli at the prespecified concentrations of ciprofloxacin per participant and per time point (baseline and after administration of the intervention/placebo)., Percentage of inhibited E. coli ciprofloxacin MIC ≥ 0.125 mg/L per participant and per time point (baseline and after administration of the intervention/placebo). This coincides with the sum of % inhibited at ciprofloxacin MIC = 0.125 mg/L and ciprofloxacin MIC = 0.250 mg/L., All above mentioned endpoints will be repeated for “non-E.coli coliforms", Concentration of ciprofloxacin in feces at day 0 and 30

Source: https://euclinicaltrials.eu/ctis-public/view/2023-506205-18-00